EU clinical trial 2024-517290-24-00: A Phase II Randomized, Open-label, Multi-center Study of the Safety and Efficacy of IMCgp100 Compared with Investigator’s Choice in HLA-A*0201 Positive Patients with Previously Untreated Advanced Uveal Melanoma
Protocol code: IMCgp100-202
Sponsor: Immunocore Limited (Pharmaceutical company). Phase: Therapeutic exploratory (Phase II). Countries: Spain (ended), Italy (ended), Belgium (ended), France (ended), Poland (ended).
Therapeutic area(s): Diseases [C] - Neoplasms [C04]
Gender: Female, Male. Age: 18-64 years, 65+ years. Enrolment: 96.
Status: Ended. Start date (EU): 2017-12-19. End date (EU): 2025-09-17. End date: 2025-09-18. Decision date: 2024-11-07. Results received: No. Last updated: 2025-06-25.
Decision dates by country: PL: 2024-11-07, ES: 2024-11-15, FR: 2024-11-13, IT: 2024-11-11, BE: 2024-11-07

Condition(s): Previously untreated advanced uveal melanoma (UM)
Product: YERVOY 5 mg/ml concentrate for solution for infusion, KEYTRUDA 25 mg/mL concentrate for solution for infusion, KIMMTRAK 100 micrograms/0.5 mL concentrate for solution for infusion, DACARBAZINE

Primary endpoint: Overall survival, date of death in relation to study randomization
Endpoint(s): Safety and tolerability: Incidence and severity of AEs and SAEs; changes in safety laboratory parameters, vital signs, and electrocardiogram (QTcF); dose interruptions, reductions, discontinuations, and dose intensity of all administered agents, Serum PK parameters (eg, Cmax, Cmin, Ctrough), • PFS • BOR • DOR • Time to response DCR (defined as CR or PR, or SD ≥ 24 weeks), EQ-5D,5L and EORTC QLQ-C30 change from Baseline over time and between treatment strategies, Assessments of anti-tebentafusp antibody formation

Source: https://euclinicaltrials.eu/ctis-public/view/2024-517290-24-00